EU clinical trial 2024-512108-20-00: A Multicenter, Long-Term Open-Label Safety Study of Adjunctive Troriluzole in Subjects with Obsessive Compulsive Disorder
Sponsor: Biohaven Pharmaceuticals Inc. (Pharmaceutical company). Phase: Therapeutic confirmatory (Phase III). Countries: Italy (ended), Spain (ended).
Therapeutic area(s): Psychiatry and Psychology [F] - Behavioral Disciplines and Activities [F04]
Gender: Female, Male. Age: 18-64 years, 65+ years. Enrolment: 43.
Status: Ended. Start date (EU): 2022-03-16. End date (EU): 2026-02-13. End date: 2026-02-14. Decision date: 2024-07-01. Results received: No. Last updated: 2025-10-29.
Decision dates by country: IT: 2024-07-02, ES: 2024-07-01

Condition(s): Obsessive Compulsive Disorder
Product: Troriluzole, Troriluzole

Primary endpoint: Safety and tolerability are assessed using the frequency of unique subjects with: SAE; AEs leading to discontinuation; AEs judged to be related to study medication; and clinically significant laboratory abnormalities that are observed over the course of treatment.

Source: https://euclinicaltrials.eu/ctis-public/view/2024-512108-20-00